EU clinical trial 2024-511656-41-00: An Open-Label Extension Study to Evaluate the Long-term Safety and Efficacy of Weekly Intravenous Infusions of BMN 351 in Participants with Duchenne Muscular Dystrophy Amenable to Exon 51 Skipping
Protocol code: 351-202
Sponsor: Biomarin Pharmaceutical Inc. (Pharmaceutical company). Phase: Therapeutic exploratory (Phase II). Countries: Spain (ongoing, recruiting), Italy (ongoing, recruiting), Netherlands (ongoing, recruiting).
Therapeutic area(s): Diseases [C] - Musculoskeletal Diseases [C05]
Gender: Male. Age: 0-17 years, 18-64 years. Enrolment: 5.
Status: Ongoing, recruiting. Start date (EU): 2026-04-15. Decision date: 2026-03-16. Results received: No. Last updated: 2026-03-20.
Decision dates by country: IT: 2026-03-16, ES: 2026-03-20, NL: 2026-03-16

Condition(s): Duchenne Muscular Dystrophy
Product: Exon 51 specific phosphorothioate oligonucleotide

Primary endpoint: Incidence of adverse events/SAEs/AESI, physical examination, safety laboratory test parameters, ECG parameters, echocardiogram
Endpoint(s): NSAA (total score and selected individual components, i.e., timed 10MWRT and TTR) at baseline and subsequent Q24W visits, Timed 4SC at baseline and subsequent Q24W visits, SV95C (4-week monitoring periods preceding baseline and subsequent Q24W visits), PUL 2.0 at baseline and subsequent Q24W visits

Source: https://euclinicaltrials.eu/ctis-public/view/2024-511656-41-00